EU clinical trial 2022-501238-52-00: A Phase 2/3 Randomized, Placebo-Controlled, Double-blind, Clinical Study to Evaluate the Efficacy, Safety, and Pharmacokinetics of Vericiguat in Pediatric Participants with Heart Failure due to Systemic Left Ventricular Systolic Dysfunction (VALOR)
Protocol code: MK-1242-036
Sponsor: Merck Sharp & Dohme LLC (Pharmaceutical company). Phase: Phase II and Phase III (Integrated). Countries: Netherlands (authorised, recruiting), Hungary (ongoing, recruiting), Portugal (ongoing, recruiting), France (ended), Denmark (ongoing, recruiting), Spain (ongoing, recruiting), Finland (authorised, recruiting), Sweden (ongoing, recruiting), Poland (ended), Ireland (ongoing, recruiting), Germany (ongoing, recruiting), Belgium (ongoing, recruiting), Italy (ongoing, recruiting), Croatia (authorised, recruiting).
Therapeutic area(s): Diseases [C] - Cardiovascular Diseases [C14]
Gender: Female, Male. Age: 0-17 years. Enrolment: 111.
Start date (EU): 2023-03-23. Decision date: 2023-02-24. Results received: No. Last updated: 2026-06-24.
Decision dates by country: HU: 2023-03-03, DE: 2023-05-31, PL: 2023-03-01, FR: 2023-02-27, PT: 2023-04-20, NL: 2023-02-27, FI: 2023-02-27, SE: 2023-04-19, ES: 2023-02-24, HR: 2025-08-01, IT: 2023-07-31, DK: 2023-03-01, IE: 2023-03-03, BE: 2023-07-07

Condition(s): Heart failure due to systemic left ventricular systolic dysfunction
Product: Vericiguat, Vericiguat, Vericiguat, Vericiguat, Placebo to MK-1242 tablet 2.5 ; 5 and 10 mg; and oral suspension

Primary endpoint: Base Period: Change from baseline to Week 16 in log-transformed n-terminal pro-brain natriuretic peptide (NT-proBNP), Extension Period: Percentage of participants with one or more adverse events (AE), Extension Period: Percentage of participants who discontinued study drug due to an AE
Endpoint(s): Base Period: Change from baseline to Week 52 in log-transformed NT-proBNP, Base Period: Time from randomization to the first event of cardiovascular (CV) death, heart failure hospitalization (HFH), or worsening of heart failure (HF) without hospitalization, Base Period: Percentage of participants with one or more adverse events (AE), Base Period: Percentage of participants who discontinued study drug due to an AE, Base Period: Area under the curve from time 0-24 hours post-dose (AUC0-24) of plasma vericiguat, Base Period: Half-life (t1/2) of vericiguat in plasma, Base Period: Oral clearance (CL/F) of plasma vericiguat, Extension Period: Change from extension period baseline to extension period Week 16 in NT-proBNP

Source: https://euclinicaltrials.eu/ctis-public/view/2022-501238-52-00